EU clinical trial 2024-519469-23-00: A Long-Term Extension Study to Evaluate Safety and Efficacy of Verekitug (UPB-101) in Adult Participants with Severe Asthma who Completed the VALIANT Trial
Protocol code: UPB-CP-05
Sponsor: Upstream Bio Inc. (Pharmaceutical company). Phase: Therapeutic exploratory (Phase II). Countries: Germany (ongoing, recruitment ended), Spain (ongoing, recruitment ended), Bulgaria (ongoing, recruitment ended), Czechia (ongoing, recruitment ended), Italy (ongoing, recruitment ended), Poland (ongoing, recruitment ended).
Therapeutic area(s): Diseases [C] - Respiratory Tract Diseases [C08]
Gender: Female, Male. Age: 18-64 years, 65+ years. Enrolment: 123.
Status: Ongoing, recruitment ended. Start date (EU): 2025-10-20. Decision date: 2025-08-07. Results received: No. Last updated: 2026-06-08.
Decision dates by country: CZ: 2025-08-07, ES: 2025-08-11, DE: 2025-08-11, PL: 2025-08-11, BG: 2025-08-12, IT: 2025-08-08

Condition(s): Severe Asthma
Product: Veritikug (UPB-101) matching solution for subcutaneous injection with no active treatment, Verekitug (UPB-101)

Primary endpoint: To check if verekitug is safe, participants will be monitored for any side effects from the time the participant agrees to join the study until the participant completes the study. Participants will also have physical examinations, clinical laboratory assessments, vital sign measurements, and ECGs from the first LTE study visit, or last VALIANT study visit, until the participant completes the LTE study.
Endpoint(s): To check the effects of verekitug, the number of severe asthma flare-ups or attacks that require treatment with steroids over 60 weeks of treatment will be recorded., The change in the following from the start of the LTE study up to Week 60 will be recorded: how much air the participant can forcefully exhale in 1 second; how much nitric oxide is in the exhaled air as a measure of airway inflammation; and how well the participant’s asthma is being managed via a scored questionnaire about asthma symptoms and treatment., The amount of verekitug in the blood will be measured at each visit to see how the body processes verekitug. The blood will also be checked for antibodies against verekitug during the LTE study (from the first to last visit) to check for an immune response.

Source: https://euclinicaltrials.eu/ctis-public/view/2024-519469-23-00